EU clinical trial 2024-519126-20-00: Benefit of GnRH Agonist Before Frozen Embryo Transfer in Patients With Endometriosis and/or Adenomyosis: Randomised Prospective Study.
Protocol code: 2019_0012
Sponsor: Hospital Foch (Hospital/Clinic/Other health care facility). Phase: Phase III and phase IV (Integrated). Countries: France (authorised, recruiting).
Therapeutic area(s): Diseases [C] - Female Urogenital Diseases and Pregnancy Complications [C13]
Gender: Female. Age: 18-64 years. Enrolment: 180.
Status: Authorised, recruiting. Start date (EU): 2024-11-15. Decision date: 2024-11-15. Results received: No. Last updated: 2025-07-31.

Condition(s): Endometriosis, adenomyosis
Product: DECAPEPTYL L.P. 11,25 mg, poudre et solvant pour suspension injectable (IM ou SC) forme à libération prolongée sur 3 mois

Primary endpoint: The primary evaluation criterion is the clinical pregnancy rate (confirmed by the presence of a fetal heartbeat), which will be assessed in both groups during the ultrasound conducted at the final visit
Endpoint(s): Number of successful implantations per number of embryos transferred;, Miscarriage defined as a spontaneous pregnancy loss after a successful implantation;, Incidence and severity of side effects related to hypoestrogenism (e.g., hot flashes, night sweats, decreased libido, mood swings, etc.)

Source: https://euclinicaltrials.eu/ctis-public/view/2024-519126-20-00